EU clinical trial 2023-509119-99-00: AN OPEN-LABEL PHASE 2 STUDY TO EVALUATE PT2977 FOR THE TREATMENT OF VONHIPPEL-LINDAU DISEASE-ASSOCIATED RENAL CELL CARCINOMA
Protocol code: PT2977-202/MK6482004
Sponsor: Peloton Therapeutics Inc. (Pharmaceutical company). Phase: Therapeutic exploratory (Phase II). Countries: Denmark (ongoing, recruitment ended), France (ongoing, recruitment ended).
Therapeutic area(s): Diseases [C] - Neoplasms [C04]
Gender: Female, Male. Age: 18-64 years, 65+ years. Enrolment: 12.
Status: Ongoing, recruitment ended. Start date (EU): 2019-01-02. Decision date: 2024-07-10. Results received: No. Last updated: 2026-07-06.
Decision dates by country: DK: 2024-07-10, FR: 2024-07-11

Condition(s): Von Hippel-Lindau disease-associated Renal Cell Carcinoma
Product: Belzutifan

Primary endpoint: Overall response rate (ORR) in VHL disease-associated RCC tumors, defined as proportion of patients with a best confirmed response of CR or PR as determined by RECIST 1.1 and as assessed by an IRC.
Endpoint(s): Duration of response (DOR) in VHL disease-associated RCC tumors, defined as the interval from the first documentation of response, as determined by RECIST 1.1, to the earlier of the first documentation of disease progression or death from any cause, and calculated for patients with a best confirmed response of CR or PR., Time to response (TTR) in VHL disease-associated RCC tumors, defined as the interval from the start of study treatment to the first documentation of a response, as determined by RECIST 1.1, and calculated for patients with a best confirmed response of CR or PR., Progression-free survival (PFS) in VHL disease-associated RCC tumors, defined as the interval from the start of study treatment until the earlier of the first documentation of disease progression determined by RECIST 1.1 or death from any cause., Time to surgery (TTS) for VHL disease-associated RCC tumors, defined as the interval from the start of study treatment to the date of surgery., ORR, DOR, TTR, PFS, and TTS for non-RCC tumors associated with VHL disease in individual organ systems., Pharmacokinetics will be evaluated.

Source: https://euclinicaltrials.eu/ctis-public/view/2023-509119-99-00